EU clinical trial 2024-512058-11-00: First-in-human Trial of DS-2243a in Participants with Advanced Solid Tumors
Protocol code: DS2243-054
Sponsor: Daiichi Sankyo Inc. (Pharmaceutical company). Phase: Human Pharmacology (Phase I)- First administration to humans. Countries: France (ongoing, recruiting), Belgium (ongoing, recruiting), Netherlands (ongoing, recruiting).
Therapeutic area(s): Diseases [C] - Neoplasms [C04]
Gender: Female, Male. Age: 18-64 years, 65+ years. Enrolment: 45.
Status: Ongoing, recruiting. Start date (EU): 2025-04-09. Decision date: 2025-02-05. Results received: No. Last updated: 2026-07-16.
Decision dates by country: FR: 2025-02-05, NL: 2025-02-10, BE: 2025-02-10

Condition(s): Advanced Solid Tumor

Source: https://euclinicaltrials.eu/ctis-public/view/2024-512058-11-00